EU clinical trial 2024-514400-14-00: Safety of Atezolizumab/Bevacizumab in liver transplanted patients with advanced hepatocellular carcinoma (IMMUNO-TH)
Sponsor: Assistance Publique Hopitaux De Paris (Hospital/Clinic/Other health care facility). Phase: Therapeutic exploratory (Phase II). Countries: France (ongoing, recruiting).
Therapeutic area(s): Diseases [C] - Neoplasms [C04]; Diseases [C] - Digestive System Diseases [C06]
Gender: Female, Male. Age: 18-64 years, 65+ years. Enrolment: 64.
Status: Ongoing, recruiting. Start date (EU): 2026-01-23. Decision date: 2025-03-19. Results received: No. Last updated: 2025-11-12.

Condition(s): liver transplanted patients with advanced hepatocellular carcinoma
Product: BEVACIZUMAB, ATEZOLIZUMAB

Primary endpoint: Rate of ACR (defined by a Histological Banff score ≥ 5) at 6 months (confirmed by a second external expert center (Pr Calderaro, Mondor hospital).
Endpoint(s): Rate of ACR (defined by a Histological Banff score ≥ 5) at 24 months and at the end of Atezo-Beva treatment (confirmed by a second external expert center (Pr Calderaro, Mondor hospital)., The PFS defined as the time from inclusion to disease progression according to RECIST 1.1 on imaging (CT-scan) performed every 3 months or death from any cause, whichever occurred first., The OS defined by the time from inclusion to death from any cause., The ORR at 12 months is defined as the percentage of patients with a confirmed complete or partial response according to RECIST 1.1 criteria on imaging (CT-scan) performed every 3 months., -The Duration of response is defined by the time from first documentation of complete or partial response to disease progression or death according to RECIST 1.1 criteria on imaging (CT-scan) performed every 3 months., The time to deterioration of quality of life is defined as the time from inclusion to the first deterioration of quality of life as reported by the patient, with deterioration defined as a decrease from baseline of 10 points or more on the EORTC QLQ–C30 maintained for two consecutive assessments or a decrease of 10 points or more in one assessment followed by death from any cause within 3 weeks. Each quality of life evaluation will be reported by the patient using EORTC QLQ-C30 score fill formed, Safety and adverse event will be assessed on the basis of the nature, frequency and severity of adverse events according to NCI Common Terminology Criteria for Adverse Events, version 4.0. The management of side effects usually observed under immunotherapy will be managed according to the American Society of Clinical Oncology Clinical Practice Guidelines (33)., DSA will be assessed before the first injection and at D21, M3, M6, M12, M18, M24, and correlated to ACR, the PFS and OS will be evaluated. Dosage of DSA will be centralized in Pr Taupin’s lab (Hôpital Saint Louis, Paris).

Source: https://euclinicaltrials.eu/ctis-public/view/2024-514400-14-00